EU clinical trial 2023-510511-19-00: A Phase 1/2, First-In-Human, Multi-Part, Open Label, Multiple-Ascending Dose Study to Investigate the Safety, Tolerability, Pharmacokinetics, Biological, and Clinical Activity of DF6002 as a Monotherapy and in Combination with Nivolumab in Patients With Locally Advanced or Metastatic Solid Tumors, and Expansion in Selected Indications
Protocol code: DF6002-001
Sponsor: Dragonfly Therapeutics Inc. (Pharmaceutical company). Phase: Phase I and Phase II (Integrated)- First administration to humans. Countries: France (ended), Spain (ended).
Therapeutic area(s): Diseases [C] - Neoplasms [C04]
Gender: Female, Male. Age: 18-64 years, 65+ years. Enrolment: 95.
Status: Ended. Start date (EU): 2021-11-08. End date (EU): 2025-11-19. End date: 2025-11-26. Decision date: 2024-03-25. Results received: No. Last updated: 2025-04-25.
Decision dates by country: FR: 2024-04-01, ES: 2024-03-25

Condition(s): Advanced Solid Tumors
Product: OPDIVO 10 mg/mL concentrate for solution for infusion., DF6002

Primary endpoint: The primary endpoints in Phase 1/1b are: Occurrence of DLTs during the first 3 weeks of treatment., The primary endpoints in Phase 2 are, for each cohort: Confirmed ORR, per RECIST 1.1, as adjudicated by an IERC.
Endpoint(s): 1. Phase 1/1b Number, severity, and duration of treatment emergent AEs (TEAEs) for all dose groups/indications according to the National Cancer Institute Common Terminology Criteria for Adverse Events (NCI CTCAE), v5.0., 2. Phase 1/1b Change from baseline in laboratory parameters, electrocardiograms (ECGs), vital signs, and Eastern Cooperative Oncology Group (ECOG) performance status., 3. Phase 1/1b DOR according to RECIST 1.1, per Investigator assessment., 4. Phase 1/1b PK parameters for DF6002 (including AUC0-t, AUC0-∞, , Cmax, tmax, and t½, trough concentration [Ctrough]), and nivolumab (concentration at the end of the infusion [Ceoi] and Ctrough), 5. Phase 1/1b BOR, according to RECIST 1.1, per Investigator assessment., 6. Phase 1/1b CBR according to RECIST 1.1, per Investigator assessment., 7. Phase 1/1bThe confirmed ORR, per RECIST 1.1, per investigator assessment., 8. Phase 2 Number, severity, and duration of TEAEs for all dose groups/indications according to the NCI-CTCAE v5.0., 9. Phase 2 Change from baseline in laboratory parameters, ECGs, vital signs, and ECOG performance status., 10. Phase 2 BOR according to RECIST 1.1, per Investigator assessment., 11. Phase 2 PFS according to RECIST 1.1, per Investigator assessment, 12. Phase 2 CBR according to RECIST 1.1, per Investigator assessment, 13. Phase 2 DOR according to RECIST 1.1, per Investigator assessment, 14. Phase 2 CBR according to RECIST 1.1, per IERC., 15. Phase 2 PFS according to RECIST 1.1, per IERC., 16. Phase 2 DOR according to RECIST 1.1, per IERC., 17. Phase 2 Unconfirmed response after 4 cycles according to RECIST 1.1., 18. Phase 2 PK parameters (including AUC0-t, AUC0-∞, , Cmax, Ctrough, tmax, and t½) (all cohorts) and additionally for nivolumab (Ceoi and Ctrough) (Cohort 2C and Cohort 2D).

Source: https://euclinicaltrials.eu/ctis-public/view/2023-510511-19-00